EU clinical trial 2024-515389-15-00: Phase 2b randomized, double-blind, placebo-controlled crossover study evaluating the efficacy and safety of zagociguat in participants with MELAS (PRIZM)
Protocol code: TIS6463-203
Sponsor: Tisento Therapeutics Inc. (Laboratory/Research/Testing facility). Phase: Therapeutic exploratory (Phase II). Countries: Italy (ended), Germany (ended).
Therapeutic area(s): Diseases [C] - Congenital, Hereditary, and Neonatal Diseases and Abnormalities [C16]
Gender: Female, Male. Age: 18-64 years, 65+ years. Enrolment: 20.
Status: Ended. Start date (EU): 2024-12-13. End date (EU): 2026-06-29. Decision date: 2024-10-16. Results received: No. Last updated: 2026-06-03.
Decision dates by country: DE: 2024-10-16, IT: 2024-10-23

Condition(s): Mitochondrial encephalomyopathy, lactic acidosis, and stroke-like episodes (MELAS)
Product: zagociguat 7.5 mg, zagociguat 15 mg, Placebo-to-match (ptm) zagociguat 15mg tablets, Placebo-to-match (ptm) zagociguat 7.5mg tablets

Primary endpoint: For Week 9 through 12 • PROMIS Fatigue MELAS Short Form (PFM-SF) scores • Groton Maze Learning Test (GMLT) scores • International Digit Symbol Substitution Test (iDSST) scores These 3 endpoints (with weights of 0.4, 0.3, and 0.3, respectively) will be combined using a global statistical test (GST), Incidence of treatment-emergent adverse events (TEAEs) from study drug initiation through the Follow-up Visit or end of treatment if a participant continues to the open-label extension study.
Endpoint(s): Number of repetitions completed during the 30-second sit-to-stand test at Week 12, PROMIS Cognitive Function MELAS Short Form (PCFM-SF) score for Week 12, Concentrations of GDF-15 at Week 12, Memory composite scores (One Card Learning and One Back Tests) for Week 9 through 12

Source: https://euclinicaltrials.eu/ctis-public/view/2024-515389-15-00